EU clinical trial 2024-512397-95-00: Extended Criteria Treatment for Liver Metastases With Heavy Tumour Burden
Sponsor: Oslo University Hospital HF (Hospital/Clinic/Other health care facility). Phase: Therapeutic exploratory (Phase II). Countries: Norway (temporarily halted).
Therapeutic area(s): Diseases [C] - Digestive System Diseases [C06]; Analytical, Diagnostic and Therapeutic Techniques and Equipment [E] - Therapeutics [E02]; Phenomena and Processes [G] - Digestive System and Oral Physiological Phenomena [G10]
Gender: Female, Male. Age: 18-64 years, 65+ years. Enrolment: 97.
Status: Temporarily halted. Start date (EU): 2026-05-21. Decision date: 2024-07-15. Results received: No. Last updated: 2026-05-20.

Condition(s): Colorectal Liver Metastases
Product: HEPARIN, Floxuridine, DEXAMETHASONE, HEPARIN, DEXAMETHASONE SODIUM PHOSPHATE

Primary endpoint: Overall Survival at two years
Endpoint(s): Progression-free survival, Overall survival at 5 years, Resection/transplantation rate, Quality of life

Source: https://euclinicaltrials.eu/ctis-public/view/2024-512397-95-00